EU clinical trial 2025-523579-47-00: An Extension Study to Evaluate the Long-Term Safety and Efficacy of Afimkibart (RO7790121) in Patients with Rheumatoid Arthritis who Participated in Previous Afimkibart Clinical Trials
Protocol code: WA46440
Sponsor: F. Hoffmann-La Roche AG (Pharmaceutical company). Phase: Therapeutic exploratory (Phase II). Countries: Italy (authorised, recruiting), Spain (authorised, recruiting), Germany (authorised, recruiting), France (authorised, recruiting), Denmark (authorised, recruiting), Poland (authorised, recruiting), Belgium (authorised, recruiting).
Therapeutic area(s): Phenomena and Processes [G] - Immune System Phenomena [G13]; Diseases [C] - Immune System Diseases [C20]
Gender: Female, Male. Age: 18-64 years, 65+ years. Enrolment: 46.
Status: Authorised, recruiting. Start date (EU): 2026-06-19. Decision date: 2026-05-27. Results received: No. Last updated: 2026-07-20.
Decision dates by country: BE: 2026-05-27, DK: 2026-05-28, FR: 2026-05-28, DE: 2026-05-29, IT: 2026-05-28, PL: 2026-05-29, ES: 2026-06-01

Condition(s): moderate to severe rheumatoid arthritis (RA)
Product: RO7790121, RO7790121

Primary endpoint: Incidence and severity of adverse events, serious adverse events, adverse events leading to study treatment discontinuation, adverse events of special interest
Endpoint(s): Proportion of participants with American College of Rheumatology ACR20, ACR50, and ACR70 response (improvements will be assessed using the baseline of the parent study), Change from baseline DAS28-CRP), Proportion of participants achieving LDA, CR based on DAS28-CRP, DAS28-ESR, CDAI, or SDAI, Change from baseline in selected clinical laboratory test results, Change from baseline in selected vital signs, Serum concentration of afimkibart at specified timepoints

Source: https://euclinicaltrials.eu/ctis-public/view/2025-523579-47-00